EU clinical trial 2024-513081-19-00: HPV2-2303 - Phase 2 clinical trial evaluating secondary HPV vaccination after treatment of high-grade cervical lesions
Protocol code: HPV2-2303
Sponsor: Centre Oscar Lambret (Pharmaceutical company). Phase: Therapeutic exploratory (Phase II). Countries: France (ongoing, recruiting).
Therapeutic area(s): Diseases [C] - Neoplasms [C04]
Gender: Female. Age: 18-64 years. Enrolment: 85.
Status: Ongoing, recruiting. Start date (EU): 2024-12-24. Decision date: 2024-10-21. Results received: No. Last updated: 2026-01-08.

Condition(s): high-grade cervical intraepithelial lesions
Product: Gardasil 9 suspension for injection. Human Papillomavirus 9-valent Vaccine (Recombinant, adsorbed)

Primary endpoint: HPV-negative status within 24 months of the initial HPV control test, HPV-negative statu is defined as a negative. If the patient cannot be assessed at 2 years due to the occurrence of cancer beforehand, the observation will be considered a failure (equivalent to the absence of negativation).
Endpoint(s): HPV status over time assessed by smear every 12 months until HPV-negative status (in the study: within 5 years of follow-up). When the test is negative, a follow-up smear is performed three years later (in the study: within 5 years of follow-up)., Adverse Events (AEs) will be assessed according to the NCI-CTCAE V5.0 over the total duration of the vaccination schedule plus 30 days. AEs will be collected after each injection, at the next injection for the first 2 injections, and by a telephone call (+/- consultation if necessary) at 30 days after the 3rd injection. AEs clearly related to the underlying disease or its progression will be excluded. Grade ≥3 AEs will be considered as severe AEs. All serious adverse events will be reported im, To estimate the incidence of recurrence of high-grade intraepithelial lesion, we will calculate the time between the date of the initial HPV control test and the first of the event (recurrence of high-grade intraepithelial lesion of the uterine cervix, occurrence of HPV-related cancer whatever the location: uterine cervix, vagina, vulva)., To estimate the incidence of invasive gynaecological cancer (cervix, vagina or vulva), we will calculate the time between the date of the initial HPV control test and the occurrence of HPV-related invasive cancer at any location (cervix, vagina, vulva)., Compliance with the vaccination schedule will be assessed by o the number of injections received o the timing of injections (time to start vaccination, time between each injections, time between the 1st and 3rd injections).

Source: https://euclinicaltrials.eu/ctis-public/view/2024-513081-19-00